EU clinical trial 2024-514007-34-00: An Extension Trial Evaluating the Long-term Safety and Efficacy of Dasiglucagon for the Treatment of Children with Congenital Hyperinsulinism
Protocol code: ZP4207-17106
Sponsor: Zealand Pharma A/S (Pharmaceutical company). Phase: Therapeutic confirmatory (Phase III). Countries: Germany (ended).
Therapeutic area(s): Diseases [C] - Congenital, Hereditary, and Neonatal Diseases and Abnormalities [C16]
Gender: Female, Male. Age: 0-17 years. Enrolment: 7.
Status: Ended. Start date (EU): 2020-03-08. End date (EU): 2024-12-06. End date: 2026-05-26. Decision date: 2024-08-09. Results received: Yes. Last updated: 2024-08-09.

Condition(s): Children with congenital hyperinsulinism
Product: Dasiglucagon 4 mg/ml

Primary endpoint: Adverse events
Endpoint(s): Total amount of gastric carbohydrates administered (nasogastric [NG] tube or gastrostomy) to treat hypoglycemia, Time to removal of NG tube or gastrostomy, Time to pancreatic surgery (sub-total or total pancreatectomy), CGM percent time <70 mg/dL (3.9 mmol/L), Rate of CGM-detected hypoglycemia episodes <70 mg/dL (3.9 mmol/L) for 15 minutes or more, Rate of clinically significant CGM-detected hypoglycemia episodes <54 mg/dL (3.0 mmol/L) for 15 minutes or more

Source: https://euclinicaltrials.eu/ctis-public/view/2024-514007-34-00